EU clinical trial 2024-514920-18-00: ABIMMUNE: A Phase I/II study evaluating the safety and clinical activity of anti-PDL1 (Durvalumab [MEDI4736]) + Anti CTLA-4 (Tremelimumab) antibodies administrated in combination with stereotactic body radiotherapy (SBRT) in patients with metastatic squamous cell carcinoma of head and neck, lung, oesophageus, cervix, vagina, vulva or anus.
Protocol code: CSET N°2016/2454
Sponsor: Institut Gustave Roussy (Hospital/Clinic/Other health care facility). Phase: Phase I and Phase II (Integrated)- Other. Countries: France (ended).
Therapeutic area(s): Diseases [C] - Neoplasms [C04]
Gender: Female, Male. Age: 18-64 years, 65+ years. Enrolment: 61.
Status: Ended. Start date (EU): 2017-06-20. End date (EU): 2025-02-24. Decision date: 2024-07-09. Results received: No. Last updated: 2025-04-22.

Condition(s): Metastatic squamous cell carcinoma of head and neck, lung, esophagus, cervix, vagina, vulva or anus to be treated with SBRT
Product: IMFINZI 50 mg/mL concentrate for solution for infusion., IMJUDO 20 mg/ml concentrate for solution for infusion.

Primary endpoint: Phase I: dose limiting toxicities (AE assessed using CTCAE v 4.03), Phase II: CT-SCAN evaluation outside the field of focal radiotherapy
Endpoint(s): RECIST 1.1 and irRC, Adverse events based on CTCAE-V4

Source: https://euclinicaltrials.eu/ctis-public/view/2024-514920-18-00